EU clinical trial 2024-517504-11-00: PeRinatal Outcomes with ACTive versus expectant management of women with Pre-labor Rupture Of Membranes: a phase III, open-label, randomized controlled multicentric trial
Sponsor: Azienda Ospedaliero Universitaria Di Modena (Hospital/Clinic/Other health care facility). Phase: Therapeutic confirmatory (Phase III). Countries: Italy (ongoing, recruiting).
Therapeutic area(s): Diseases [C] - Female Urogenital Diseases and Pregnancy Complications [C13]
Gender: Female. Age: 18-64 years. Enrolment: 1400.
Status: Ongoing, recruiting. Start date (EU): 2025-01-29. Decision date: 2025-01-29. Results received: No. Last updated: 2026-01-19.

Condition(s): Pregnant patients diagnosed with premature rupture of membranes (PROM)
Product: DINOPROSTONE, MISOPROSTOL, DINOPROSTONE, OXYTOCIN

Primary endpoint: The need for Neonatal ventilatory support will be evaluated at delivery and include at least one of the following measures: • Free-flowing oxygen in incubator • Low flow oxygen (≤ 2LPM) • High flow oxygen (≥ 3 LPM) • NCPAP or other NIV • Mechanical ventilation
Endpoint(s): Intraamniotic infection is evaluated by the objective measurement of maternal temperature, fetaltachycardia maternal white blood cells > 15000 per mm3, loss of purulent amniotic fluid in labor., Maternal infection will be evaluated on mothers re-admitted in the hospital until post-partum day 42 because of fever, purulent vaginal discharge or surgical site infection. Length of hospital stay will be recorded as a proxy of maternal/newborn complications. Maternal administration of antibiotics will be reported in terms of doses and quality, Neonatal infection is defined as the yield of a pathogen from blood or CSF coltures. Suspected infection is based on the presence of clinical symptoms and abnormal laboratory markers, i.e. an increase in C reactive proteins above 1.5 mg/dl., Neonatal pneumonia will be diagnosed in presence of a radiological evidence of persistent consolidation, cavitation or pleural effusion and evidence of worsening gas exchange associated with at least three clinical and/or laboratoristic signs Neonatal administration of antibiotics will be reported in terms of doses and quality, Tachysystole is defined as more of 5 uterine contractions in 10 minutes

Source: https://euclinicaltrials.eu/ctis-public/view/2024-517504-11-00